EU clinical trial 2024-513416-98-00: Adipose Tissue Heterogeneity and Its Link to Type 2 Diabetes: A Randomized Open Intervention Study That Compares Empagliflozin, Pioglitazone and Semaglutide (DiaSpax)
Sponsor: Karolinska University Hospital (Hospital/Clinic/Other health care facility). Phase: Therapeutic exploratory (Phase II). Countries: Sweden (ongoing, recruiting), Denmark (authorised, recruitment pending).
Therapeutic area(s): Diseases [C] - Nutritional and Metabolic Diseases [C18]
Gender: Female, Male. Age: 18-64 years, 65+ years. Enrolment: 90.
Start date (EU): 2023-01-23. Decision date: 2024-06-11. Results received: No. Last updated: 2025-11-25.
Decision dates by country: DK: 2025-03-13, SE: 2024-06-11

Condition(s): Diabetes type 2
Product: Actos 30 mg tablets, Jardiance 25 mg film-coated tablets, Rybelsus 7 mg tablets, Actos 45 mg tablets, Rybelsus 14 mg tablets, Actos 15 mg tablets, Jardiance 10 mg film-coated tablets, Rybelsus 3 mg tablets

Primary endpoint: Lipolysis is measured as basal and maximal isoprenaline-stimulated lipolysis in isolated adipocytes from the subcutaneous abdominal periumbilical adipose tissue and expressed as log10 ISO-stimulated/basal glycerol release ex vivo
Endpoint(s): The cellular heterogeneity of adipose tissue (i.e., different adipocyte subtypes) is measured using qPCR of ADIPOQ/LEP in the same adipose tissue samples from which lipolysis is measured.

Source: https://euclinicaltrials.eu/ctis-public/view/2024-513416-98-00